EU clinical trial 2025-523530-30-00: Single-centre clinical trial investigating the safety and tolerability of increasing multiple doses of nebulised SS0331 in healthy participants
Protocol code: SIS-02
Sponsor: Softox Defense Solutions AS (Pharmaceutical company). Phase: Human Pharmacology (Phase I)- First administration to humans. Countries: Ireland (ongoing, recruiting).
Therapeutic area(s): Diseases [C] - Bacterial Infections and Mycoses [C01]; Diseases [C] - Virus Diseases [C02]
Gender: Female, Male. Age: 18-64 years. Enrolment: 48.
Status: Ongoing, recruiting. Start date (EU): 2026-05-11. Decision date: 2026-02-20. Results received: No. Last updated: 2026-08-06.

Condition(s): Treatment and post exposure prevention of respiratory tract infection, Biologic countermeasure

Source: https://euclinicaltrials.eu/ctis-public/view/2025-523530-30-00